EU clinical trial 2022-502516-37-00: Phase IB clinical trial to assess the safety, tolerability, and preliminary efficacy of AloCELYVIR (Mesenchymal allogenic cells + ICOVIR-5) in children, adolescent and young adults with newly diagnosed diffuse intrinsic pointine glioma (DIPG) in combination with radiotherapy or medulloblastoma in relapse/progression in monotherapy.
Protocol code: FIBHNJ-2020-01
Sponsor: Fundacion Para La Investigacion Biomedica Hospital Infantil Universitario Nino Jesus (Hospital/Clinic/Other health care facility). Phase: Human Pharmacology (Phase I)- Other. Countries: Spain (ended).
Therapeutic area(s): Diseases [C] - Neoplasms [C04]
Gender: Female, Male. Age: 0-17 years, 18-64 years. Enrolment: 12.
Status: Ended. Start date (EU): 2021-07-12. End date (EU): 2026-04-09. Decision date: 2023-03-15. Results received: No. Last updated: 2023-03-15.

Condition(s): Newly diagnosed Diffuse Intrinsic Pointine Glioma (DIPG) or Medulloblastoma in relapse/progression in children, adolescents and young adults.
Product: AloCelyvir

Primary endpoint: Dose-Limiting Toxicities rate
Endpoint(s): Objective response rate, Rate of patients meeting selection criteria who can receive at least one cycle of Alo-Celyvir, Progression-free survival, Overall survival, To compare the progression-free survival and overall survival of cohort A and B with a historical cohort of newly diagnosed DIPG patients and with a historical cohort of patients with relapse medulloblastoma, Adverse Events Rate, Kinetics of anti-Adenovirus serotype 5 antibody titers, Kinetics of the number of CD8 antiadenovirus T-lymphocytes, Kinetics of circulating adenoviral particles

Source: https://euclinicaltrials.eu/ctis-public/view/2022-502516-37-00